EU clinical trial 2024-519250-37-00: Bioequivalence of One Tablet of Gliclazide MR 120 mg (S005190) and Two Tablets of Gliclazide MR 60 mg (Diamicron® MR) in Healthy Participants under Fed Conditions.
Protocol code: S005190-204
Sponsor: Institut De Recherches Internationales Servier IRIS (Pharmaceutical company). Phase: Human Pharmacology (Phase I)- Bioequivalence Study. Countries: Portugal (ended).
Therapeutic area(s): Not possible to specify
Gender: Female, Male. Age: 18-64 years. Enrolment: 36.
Status: Ended. Start date (EU): 2025-05-27. End date (EU): 2025-07-06. Decision date: 2025-03-07. Results received: No. Last updated: 2025-06-18.

Condition(s): No medical condition.

Source: https://euclinicaltrials.eu/ctis-public/view/2024-519250-37-00